EU clinical trial 2023-507749-27-00: A Long-Term Follow-Up Study in Subjects with Severe Hemophilia A Who Received BMN 270, an Adeno-Associated Virus Vector–Mediated Gene Transfer of Human Factor VIII in a Prior BioMarin Clinical Trial
Protocol code: 270-401 (GENEr8-LTE)
Sponsor: Biomarin Pharmaceutical Inc. (Pharmaceutical company). Phase: Therapeutic use (Phase IV). Countries: Italy (ended), Belgium (ended), France (ended), Spain (ended), Germany (ongoing, recruitment ended).
Therapeutic area(s): Diseases [C] - Hemic and Lymphatic Diseases [C15]
Gender: Male. Age: 18-64 years, 65+ years. Enrolment: 16.
Start date (EU): 2024-08-16. Decision date: 2024-06-18. Results received: No. Last updated: 2026-03-23.
Decision dates by country: FR: 2024-06-21, IT: 2024-06-20, DE: 2024-06-20, BE: 2024-06-18, ES: 2024-07-24

Condition(s): Hemophilia A
Product: ROCTAVIAN 2 × 1013 vector genomes/mL solution for infusion

Primary endpoint: Occurrence of adverse drug reactions, serious adverse events, and events of special interest, including: a) Hepatotoxicity; b) Thromboembolic events; c) Development of FVIII inhibitors; d) Transmission to third parties; e) Integration with theoretical risk of tumorigenesis
Endpoint(s): Changes in annualized bleeding rate (ABR) (treated bleeds and all bleeds), FVIII activity measured over time (CSA and OSA), Annualized use of concomitant hemostatic medications (annualized FVIII utilization and annualized FVIII infusion rate), Changes in Haemo-QoL-A

Source: https://euclinicaltrials.eu/ctis-public/view/2023-507749-27-00